EU clinical trial 2024-515285-14-00: Phase 1 Safety and Tolerability Study of REGN9533 in Healthy Adults.
Protocol code: R9533-HV-2411
Sponsor: Regeneron Pharmaceuticals Inc. (Pharmaceutical company). Phase: Human Pharmacology (Phase I)- First administration to humans. Countries: Belgium (ended).
Therapeutic area(s): Diseases [C] - Hemic and Lymphatic Diseases [C15]; Diseases [C] - Cardiovascular Diseases [C14]
Gender: Female, Male. Age: 18-64 years. Enrolment: 72.
Status: Ended. Start date (EU): 2025-03-04. End date (EU): 2026-01-29. Decision date: 2025-02-18. Results received: No. Last updated: 2025-02-18.

Condition(s): Healthy Volunteers

Source: https://euclinicaltrials.eu/ctis-public/view/2024-515285-14-00